EU clinical trial 2023-507449-27-01: A biomarker-targeted clinical trial to optimize treatment for patients with chronic kidney disease
Sponsor: Steno Diabetes Center Copenhagen (Hospital/Clinic/Other health care facility). Phase: Therapeutic use (Phase IV). Countries: Sweden (ongoing, recruiting), Spain (ongoing, recruiting), Denmark (ongoing, recruiting), Germany (ongoing, recruiting), Italy (authorised, recruitment pending).
Therapeutic area(s): Not possible to specify
Gender: Female, Male. Age: 18-64 years, 65+ years. Enrolment: 115.
Start date (EU): 2025-06-20. Decision date: 2025-04-08. Results received: No. Last updated: 2026-07-17.
Decision dates by country: SE: 2025-04-08, ES: 2025-04-10, DE: 2025-04-08, IT: 2026-03-05, DK: 2025-04-08

Condition(s): Chronic kidney disease
Product: BAY 94-8862, DAPAGLIFLOZIN, SEMAGLUTIDE, Finerenone

Primary endpoint: Chronic eGFR slope, defined as mean annual rate of change in eGFR from week 26 to week 104.
Endpoint(s): Change in eGFR from baseline to week 112 (end of study)., Change in eGFR from baseline to week 104 (end of treatment)., Change in albuminuria from baseline to week 104., Change in KidneyIntelX score from baseline to week 104., FOR ITALY ONLY: Change in UEGF from baseline to week 26 and association between change in uEGF and change in albuminuria (Exploratory endpoint)

Source: https://euclinicaltrials.eu/ctis-public/view/2023-507449-27-01